EU clinical trial 2025-524710-29-00: Comparing intraoperative indocyanine green fluorescence imaging with standard clinical assessment for flap perfusion in head and neck reconstruction: A randomised controlled Trial (VISION Trial)
Sponsor: Region Skane (Hospital/Clinic/Other health care facility). Phase: Therapeutic use (Phase IV). Countries: Sweden (authorised, recruitment pending).
Therapeutic area(s): Diseases [C] - Neoplasms [C04]; Diseases [C] - Otorhinolaryngologic Diseases [C09]; Diseases [C] - Skin and Connective Tissue Diseases [C17]
Gender: Female, Male. Age: 18-64 years, 65+ years. Enrolment: 244.
Status: Authorised, recruitment pending. Decision date: 2026-05-22. Results received: No. Last updated: 2026-05-22.

Condition(s): Head and neck cancer
Product: Verdye 5 mg/ml pulver till injektionsvätska, lösning

Primary endpoint: The primary endpoint is incidence of partial flap loss requiring surgical intervention within 1 month.
Endpoint(s): The secondary endpoints of this trial are total flap loss, flap related re-exploration rate in general anaesthesia and flap salvage rate within one month, and postoperative complications (graded according to the Clavien-Dindo classification) within three months.

Source: https://euclinicaltrials.eu/ctis-public/view/2025-524710-29-00